EU clinical trial 2025-522307-14-00: A Study to Evaluate the Pharmacokinetics, Efficacy, Safety and Immunogenicity of Xdivane versus Opdivo® in Patients with Resected Melanoma
Protocol code: 0439-24
Sponsor: Intas Pharmaceuticals Limited (Pharmaceutical company). Phase: Human Pharmacology (Phase I)- Bioequivalence Study. Countries: Spain (ongoing, recruiting), Romania (ongoing, recruiting).
Therapeutic area(s): Diseases [C] - Neoplasms [C04]
Gender: Female, Male. Age: 18-64 years, 65+ years. Enrolment: 34.
Status: Ongoing, recruiting. Start date (EU): 2026-01-19. Decision date: 2025-12-08. Results received: No. Last updated: 2026-02-13.
Decision dates by country: RO: 2025-12-08, ES: 2026-02-13

Condition(s): Melanoma

Source: https://euclinicaltrials.eu/ctis-public/view/2025-522307-14-00